EU clinical trial 2025-524527-46-00: A single and multiple ascending dose study of topical ladarixin ophthalmic solution in healthy volunteers
Protocol code: LDX-HV-101
Sponsor: Dompe' Farmaceutici S.p.A. (Pharmaceutical company). Phase: Human Pharmacology (Phase I)- First administration to humans. Countries: Netherlands (ended).
Therapeutic area(s): Diseases [C] - Eye Diseases [C11]
Gender: Female, Male. Age: 18-64 years. Enrolment: 16.
Status: Ended. Start date (EU): 2026-02-16. End date (EU): 2026-05-27. Decision date: 2026-02-09. Results received: No. Last updated: 2026-02-09.

Condition(s): Ocular inflammatory conditions

Source: https://euclinicaltrials.eu/ctis-public/view/2025-524527-46-00